EU clinical trial 2025-521109-42-00: First in human pilot study to assess the safety and efficacy of dendritic cells loaded with frameshift derived neopeptides for the prevention of cancer in Lynch Syndrome carriers
Protocol code: DELAY
Sponsor: Fundacio De Recerca Clinic Barcelona-Institut D’Investigacions Biomediques August Pi I Sunyer (Laboratory/Research/Testing facility). Phase: Human Pharmacology (Phase I)- First administration to humans. Countries: Spain (ongoing, recruiting).
Therapeutic area(s): Phenomena and Processes [G] - Genetic Phenomena [G05]
Gender: Female, Male. Age: 18-64 years, 65+ years. Enrolment: 20.
Status: Ongoing, recruiting. Start date (EU): 2025-08-01. Decision date: 2025-06-13. Results received: No. Last updated: 2025-06-13.

Condition(s): Lynch Syndrome

Source: https://euclinicaltrials.eu/ctis-public/view/2025-521109-42-00